EU clinical trial 2024-517799-40-00: A multicenter open-label phase II study of Cemiplimab plus chemotherapy, selected on the basis of baseline cytidine deaminase activity, in advanced squamous non-small cell lung cancer - CECYDE trial - GOIRC-04-2024
Protocol code: GOIRC-04-2024
Sponsor: G.O.I.R.C. Gruppo Oncologico Italiano Di Ricerca Clinica (Patient organisation/association). Phase: Therapeutic exploratory (Phase II). Countries: Italy (authorised, recruitment pending).
Therapeutic area(s): Diseases [C] - Neoplasms [C04]
Gender: Female, Male. Age: 18-64 years. Enrolment: 108.
Status: Authorised, recruitment pending. Decision date: 2026-07-03. Results received: No. Last updated: 2026-07-03.

Condition(s): Advanced squamous non-small cell lung cancer
Product: CEMIPLIMAB

Primary endpoint: The primary endpoint is Overall Survival (OS) that will be measured from the date of registration to the date of death by any cause and will be analyzed as 1-year survival rate in the low CDA activity cohort.
Endpoint(s): Median OS that will be measured from the date of registration to the date of death by any cause., Survival rate at 3 year and 5 years will be analysed., Progression Free Survival (PFS) that will be measured from the date of registration to the date of disease progression, based on the Investigator's assessment according to standard RECIST 1.1 criteria, or death and reported as median PFS and 6-month and 12-month PFS., Objective Response Rate (ORR) that will be defined as the sum of complete response (CR)+ partial response (PR), based on the Investigator's assessment according to standard RECIST 1.1 criteria. Patients with no tumor assessment after baseline will be classified as non-responders., Median Duration of Response (DoR) that will be measured from the date of first radiological evidence PR or CR to the date of first evidence of PD, both based on the Investigator's assessment according to standard RECIST 1.1 criteria17. Patients with no tumor assessment after baseline will be classified as non-responders., Time to tumor response (TTR) that will be defined as the time from the start of treatment to the first objective of tumor response, Disease control rate (DCR) that will be defined as the sum of complete response (CR)+ partial response (PR)+ stable disease (SD), based on the Investigator's assessment according to standard RECIST 1.1 criteria, OS, PFS and ORR will be analysed by PD-L1 levels: < 1%; 1-49%, ≥ 50%., Toxicity that will be based mainly on the frequency and severity of adverse events (all grades and grade 3-4); severity will be measured according to NCI Common terminology Criteria Adverse Event (CTCAE), version 5.0. The worst severity grade adverse event will be considered for each patient., The secondary endpoints will be analysed separately for the low and high CDA activity cohorts.

Source: https://euclinicaltrials.eu/ctis-public/view/2024-517799-40-00